EU clinical trial 2023-510248-19-00: A Randomised, Double-blind, Active-controlled 52-week Study with an Open-label Extension to Evaluate the Efficacy and Safety of Benralizumab Compared to Mepolizumab in the Treatment of Eosinophilic Granulomatosis with Polyangiitis (EGPA) in Patients Receiving Standard of Care Therapy (MANDARA Study).
Protocol code: D3253C00001
Sponsor: AstraZeneca AB (Pharmaceutical company). Phase: Therapeutic confirmatory (Phase III). Countries: Italy (ongoing, recruitment ended), France (ongoing, recruitment ended), Belgium (ended), Germany (ended).
Therapeutic area(s): Diseases [C] - Respiratory Tract Diseases [C08]
Gender: Female, Male. Age: 18-64 years, 65+ years. Enrolment: 72.
Start date (EU): 2020-01-21. Decision date: 2024-04-02. Results received: No. Last updated: 2026-07-03.
Decision dates by country: FR: 2024-04-09, DE: 2024-04-15, BE: 2024-04-09, IT: 2024-04-02

Condition(s): Eosinophilic Granulomatosis with Polyangiitis (EGPA)
Product: Placebo for mepolizumab is a 0.9% sodium chloride solution in a syringe for subcutaneous injection., PREDNISONE, Placebo for benralizumab for clinical trials is a sterile liquid solution presented in an accessorized prefilled syringe (apfs) for subcutaneous injection., Fasenra 30 mg solution for injection in pre-filled syringe, PREDNISOLONE, METHYLPREDNISOLONE, MEPOLIZUMAB

Primary endpoint: Proportion of patients with relapsing or refractory EGPA, achieving remission, defined as BVAS=0 and OCS dose ≤ 4mg/day (Main Remission definition) at both weeks 36 and 48., Supportive endpoint: Proportion of patients who have achieved remission defined by BVAS =0 and OCS dose ≤ 7.5 mg/day (Supportive remission definition) at both weeks 36 and 48.
Endpoint(s): Study secondary end point(s) – double-blind period: - Total accrued duration of remission for the following categories: 0 wk, >0 to <12 wk, 12 to <24 wk, 24 to <36 wk, ≥36 wk. Analysis will be repeated based on main and supportive remission definitions., (Part 1/2) - Time from randomisation to first EGPA relapse, where relapse is defined as any of the following: *Active vasculitis (BVAS >0); OR *Active asthma symptoms and/or signs with a corresponding worsening in ACQ-6 score; OR, (Part 2/2) *Active nasal and/or sinus disease, with a corresponding worsening in at least one of the sino-nasal symptom questions warranting any of the following: an increase of OCS therapy (>4mg prednisolone total daily dose or equivalent); an increased dose or addition of an immunosuppressive agent; Hospitalisation related to EGPA worsening., (Part 1*/2*) -Based on the average daily prednisolone/prednisone dose during Weeks 48 through 52: *Proportion of patients in each category of average daily prednisolone/prednisone dose during Weeks 48 through 52 using the following categories: 0 mg; > 0 to ≤ 4 mg; > 4 to ≤ 7.5 mg and > 7.5 mg., (Part 2*/2*) *Proportion of patients in each category of percent reduction from baseline: no reduction or withdrawal from treatment; < 25% reduction; 25 to < 50% reduction; 50 to < 75% reduction; 75 to < 100% reduction; 100% reduction. *Proportion of patients with ≥ 50% reduction from baseline. *Proportion of patients with 100% reduction from baseline. *Proportion of patients with ≤ 4 mg in average daily dose., (Part 1**/2**) - Proportion of patients who have achieved any clinical benefit when meeting any of the criteria below. Proportion of patients who have achieved complete response when meeting all of the criteria below., (Part 2**/2**) *Remission (defined as BVAS = 0 and prednisolone/prednisone dose ≤ 4 mg/day) at any time during the double-blind treatment period *≥ 50% reduction in average daily prednisolone/prednisone dose during Weeks 48 through 52 *EGPA relapse free during the double-blind treatment period. Analysis will be repeated for the supportive remission definition., - Annualized relapse rate, - Proportion of patients who have achieved remission within the first 24 weeks and remained in remission for remainder of the double-blind treatment period. Analysis will be repeated based on main and supportive remission definitions., - BVAS, VDI, pulmonary function testing, asthma symptoms (ACQ-6), SNOT-22 questionnaire, health-related quality of life (SF-36v2), WPAI and blood eosinophil counts will be assessed as change from baseline over the 52-week double-blind treatment period. Descriptive statistics will be provided for PGIS and WPAI to assess change from baseline over the 52 week double-blind period. PGIC will be assessed as response proportions at each weekly assessment between Visits 2 and 4., - Safety and tolerability will be evaluated based on AEs, Vital signs, physical exam, Clinical laboratory, and electrocardiogram (ECG)., Study end point(s) for open label extension (OLE) period: - Remission, relapse (as defined in the secondary endpoints), OCS use, -Safety and tolerability will be evaluated based on AEs, Vital signs, physical exam, Clinical laboratory, and ECG ., -Serum benralizumab concentrations, Anti-benralizumab antibodies and neutralizing antibodies.

Source: https://euclinicaltrials.eu/ctis-public/view/2023-510248-19-00